EU clinical trial 2022-502465-18-00: A phase Ib dose finding study assessing safety and activity of [177Lu]Lu-NeoB in combination with ribociclib and fulvestrant in participants with ER+, HER2- and GRPR+ advanced breast cancer who have relapsed early from (neo)adjuvant endocrine therapy or who have progressed on endocrine therapy in combination with a CDK4/6 inhibitor.
Protocol code: CAAA603B12101
Sponsor: Novartis Pharma AG (Pharmaceutical company). Phase: Phase I and Phase II (Integrated)- Other. Countries: Portugal (temporarily halted), Spain (ongoing, recruitment ended), Germany (ongoing, recruitment ended), France (ongoing, recruitment ended), Poland (ongoing, recruitment ended).
Therapeutic area(s): Diseases [C] - Neoplasms [C04]
Gender: Female, Male. Age: 18-64 years, 65+ years. Enrolment: 34.
Start date (EU): 2024-02-15. Decision date: 2023-08-21. Results received: No. Last updated: 2026-04-09.
Decision dates by country: PL: 2023-08-23, DE: 2023-08-22, PT: 2023-08-21, ES: 2023-08-23, FR: 2023-08-23

Condition(s): Advanced or metastatic breast cancer

Source: https://euclinicaltrials.eu/ctis-public/view/2022-502465-18-00